EU clinical trial 2025-522101-37-00: First-in-Human Study of RO7812653
Protocol code: BP45770
Sponsor: F. Hoffmann-La Roche AG (Pharmaceutical company). Phase: Human Pharmacology (Phase I)- First administration to humans. Countries: Sweden (ongoing, recruiting), Poland (authorised, recruitment pending), Spain (authorised, recruiting), Netherlands (authorised, recruiting).
Therapeutic area(s): Not possible to specify; Diseases [C] - Nervous System Diseases [C10]
Gender: Female, Male. Age: 18-64 years, 65+ years. Enrolment: 117.
Start date (EU): 2026-02-17. Decision date: 2025-12-02. Results received: No. Last updated: 2026-07-01.
Decision dates by country: SE: 2025-12-04, NL: 2025-12-02, PL: 2025-12-08, ES: 2025-12-03

Condition(s): Early Symptomatic Alzheimer’s Disease (eAD), (Mild Cognitive Impairment due to AD, or probable AD dementia)

Source: https://euclinicaltrials.eu/ctis-public/view/2025-522101-37-00